EU clinical trial 2024-518738-97-00: Role of Vitamin D in GVHD prophylaxis in patients undergoing allogeneic transplantation stem cells. Pilot phase II study randomized open monocentric
Protocol code: D AGAINST GVH
Sponsor: Azienda Ospedaliero Universitaria Pisana (Hospital/Clinic/Other health care facility). Phase: Therapeutic exploratory (Phase II). Countries: Italy (authorised, recruitment pending).
Therapeutic area(s): Diseases [C] - Hemic and Lymphatic Diseases [C15]
Gender: Female, Male. Age: 18-64 years, 65+ years. Enrolment: 20.
Status: Authorised, recruitment pending. Decision date: 2024-11-19. Results received: No. Last updated: 2024-11-19.

Condition(s): haematologic condition who need staminal cells transplant
Product: TREDIMIN 25.000 U.I. /2,5 ml soluzione orale

Primary endpoint: Reducing the severity of GVHD
Endpoint(s): - Evaluation of circulating lymphocyte subpopulations on peripheral blood - Assessment of vitamin D receptor (VDR) surface expression and modulation in response to vitamin D treatment on lymphocyte subpopulations. - Evaluation of the soluble fraction of VDR on serum - post hoc evaluation of the role of polymorphisms (SNPs) of recipient and donor VDR on response to vitamin D therapy - collection of any adverse events brought about by cholecalciferol intake

Source: https://euclinicaltrials.eu/ctis-public/view/2024-518738-97-00